EU clinical trial 2023-506644-17-01: Comparison of cocaine, lidocaine/xylometazoline and saline for intranasal analgesia - A blinded triple crossover study
Sponsor: Rigshospitalet (Hospital/Clinic/Other health care facility). Phase: Therapeutic confirmatory (Phase III). Countries: Denmark (ended).
Therapeutic area(s): Analytical, Diagnostic and Therapeutic Techniques and Equipment [E] - Anesthesia and Analgesia [E03]
Gender: Female, Male. Age: 18-64 years, 65+ years. Enrolment: 12.
Status: Ended. Start date (EU): 2024-07-01. End date (EU): 2024-08-27. Decision date: 2024-05-13. Results received: No. Last updated: 2024-05-13.

Condition(s): Nasotracheal intubation
Product: Natriumklorid isotonisk "SAD", injektionsvæske, opløsning, Lidokain SAD injektionsvæske, opløsning, Zymelin ukonserveret, næsespray, opløsning

Primary endpoint: Self reported pain felt during the procedure reported on a visual analogue scale of 0-100.
Endpoint(s): Self reported pain felt after one minute of tolerating the nasal tube reported on a visual analogue scale of 0-100., Acoustic rhinometry measurement with the use of the RhinoScan SRE2000, Interacoustics A/S, Assens, Denmark., Video-evaluated assessment of the degree of vasoconstriction on the nasal mucosa., Saliva samples analyzed for cocaine’s main metabolite benzoylecgonine., Blood samples analyzed for cocaine.

Source: https://euclinicaltrials.eu/ctis-public/view/2023-506644-17-01